EU clinical trial 2024-511824-15-00: A Phase 1/2 Randomized Trial of BMS-986012 in Combination with Platinum and Etoposide as First-line Therapy in Extensive-Stage Small Cell Lung Cancer
Protocol code: CA001-044
Sponsor: Bristol Myers Squibb International Corporation (Pharmaceutical company). Phase: Phase I and Phase II (Integrated)- Other. Countries: Spain (ended).
Therapeutic area(s): Diseases [C] - Neoplasms [C04]
Gender: Female, Male. Age: 18-64 years, 65+ years. Enrolment: 1.
Status: Ended. Start date (EU): 2016-10-18. End date (EU): 2024-08-06. Decision date: 2024-05-06. Results received: Yes. Last updated: 2024-05-06.

Condition(s): Extensive-Stage Small Cell Lung Cancer

Primary endpoint: Number of participants with adverse events (AEs), Number of participants with serious adverse events (SAEs), Discontinuations due to AEs, Number of participants who died due to AEs, Number of participants with laboratory toxicity grade shift from baseline, Progression Free Survival
Endpoint(s): Maximum observed serum concentration(Cmax), Time of maximum observed serum concentration(Tmax), Area under the plasma concentration-time curve from time 0 to time of last quantifiable concentration(AUC(0-T)), Observed serum concentration at the end of a dosing interval(Ctau), Area under the concentration-time curve in 1 dosing interval(AUC(TAU)), Characterization of Immunogenicity

Source: https://euclinicaltrials.eu/ctis-public/view/2024-511824-15-00